EU clinical trial 2023-503766-24-00: A Phase 3b/4 Multi-center, Randomized, Open-label, Long-term Safety Study of Deucravacitinib in Comparison to Ustekinumab in Participants with Moderate-to-Severe Plaque Psoriasis (PRAGMATYK)
Protocol code: IM011-1130
Sponsor: Bristol-Myers Squibb Services Unlimited Company (Pharmaceutical company). Phase: Phase III and phase IV (Integrated). Countries: Romania (ongoing, recruiting), Bulgaria (ongoing, recruiting), Germany (ongoing, recruiting), Spain (ongoing, recruiting), Czechia (ongoing, recruiting), France (ongoing, recruiting), Hungary (ongoing, recruiting), Italy (ongoing, recruiting), Sweden (authorised, recruitment pending), Poland (authorised, recruitment pending), Denmark (authorised, recruitment pending), Belgium (authorised, recruiting).
Therapeutic area(s): Diseases [C] - Immune System Diseases [C20]
Gender: Female, Male. Age: 18-64 years, 65+ years. Enrolment: 1289.
Start date (EU): 2026-05-26. Decision date: 2026-01-19. Results received: No. Last updated: 2026-04-20.
Decision dates by country: ES: 2026-01-26, PL: 2026-01-26, DE: 2026-01-20, RO: 2026-01-26, DK: 2026-02-02, BE: 2026-02-02, FR: 2026-02-02, IT: 2026-02-02, CZ: 2026-02-16, BG: 2026-01-22, SE: 2026-02-02, HU: 2026-01-23

Condition(s): Moderate to Severe Plaque Psoriasis
Product: USTEKINUMAB, USTEKINUMAB, deucravacitinib

Primary endpoint: Composite cardiovascular endpoint defined as: adjudicated 3-point MACE (non-fatal MI, non-fatal stroke, and cardiovascular death) plus coronary revascularization
Endpoint(s): Adjudicated events of: Non-fatal MI, non-fatal stroke, cardiovascular death, coronary revascularization, 3-point MACE (non-fatal MI, nonfatal stroke, and cardiovascular death), PE, DVT, the composite of all VTE events of PE, DVT and retinal vein occlusion, arterial thromboembolic events (including retinal artery occlusion), HF requiring hospitalization or urgent care visit, malignancy excluding NMSC, NMSC, and opportunistic infections including TB and complicated herpes zoster, SAEs, all-cause mortality, and AEs leading to permanent treatment discontinuation, Laboratory tests: complete metabolic panel, including liver function test and fasting lipid panel at baseline and every 26 weeks thereafter

Source: https://euclinicaltrials.eu/ctis-public/view/2023-503766-24-00